EU clinical trial 2024-518171-59-00: Multi-institutional Evaluation of the Cost-effectiveness of PSMA-PET/CT for the Detection of Pelvic Lymph Node Invasion in Newly Diagnosed Prostate Cancer Patients (PSMA-SELECT).
Protocol code: NL76042.091.21
Sponsor: Canisius Wilhelmina Ziekenhuis (Hospital/Clinic/Other health care facility). Phase: Phase III and phase IV (Integrated). Countries: Netherlands (ongoing, recruitment ended).
Therapeutic area(s): Diseases [C] - Male Urogenital Diseases [C12]
Gender: Male. Age: 18-64 years, 65+ years. Enrolment: 742.
Status: Ongoing, recruitment ended. Start date (EU): 2025-01-23. Decision date: 2025-01-23. Results received: No. Last updated: 2025-07-31.

Condition(s): Prostate Cancer
Product: PIFLUFOLASTAT (18F), Locametz 25 micrograms kit for radiopharmaceutical preparation, 18F-PSMA-1007

Primary endpoint: Biochemical recurrence rate within two years after surgery, defined as a PSA > 0.2 ng/ml.
Endpoint(s): - Total number of ePLNDs and PSMA PET/CTs performed and their intervention-related healthcare costs, costs of complication-related interventions and associated (prolonged) hospital stay. - Biochemical persistence, defined as PSA >0.1 within half a year after surgery - Surgical complications within 6 months after surgery. - Total nodes resected on ePLND and number of positive and negative nodes within and outside of the standard ePLND template. The necessity for a second PSMA PET / CT.

Source: https://euclinicaltrials.eu/ctis-public/view/2024-518171-59-00